EU clinical trial 2024-514311-10-00: (REGON) Repeated corticosteroid injections around the Greater Occipital Nerve (GON) as prophylactic treatment in chronic cluster headache
Protocol code: NL79665.058.22
Sponsor: Leids Universitair Medisch Centrum (LUMC) (Hospital/Clinic/Other health care facility). Phase: Therapeutic confirmatory (Phase III). Countries: Netherlands (ended).
Therapeutic area(s): Diseases [C] - Nervous System Diseases [C10]
Gender: Female, Male. Age: 18-64 years. Enrolment: 50.
Status: Ended. Start date (EU): 2024-08-10. End date (EU): 2026-04-08. Decision date: 2024-08-09. Results received: No. Last updated: 2024-11-26.

Condition(s): Cluster headache
Product: NaCl 0,9 % B. Braun, solution injectable, Depo-Medrone 40 mg/ml Suspension for Injection.

Primary endpoint: Retention rate (= time between the first injection and end-of-treatment; survival curves verum vs. placebo)
Endpoint(s): Frequency of daily cluster headache attacks, The use of acute attack medication per day (subcutaneous sumatriptan and 100% oxygen), Mean duration and severity (1-10) of attacks, Injection interval, Total number of injections in study period, Proportion of participants still in study at 1 year, Participants idea: did they receive placebo or verum?, Physician's idea: did they administer placebo or verum?, Adverse events + ultrasound structural integrity measurements greater occipital nerve, Proportion of subjects with a >50% and 100% reduction in attack frequency, Daily quality of life (EQ 5D), Healthcare use & productivity losses

Source: https://euclinicaltrials.eu/ctis-public/view/2024-514311-10-00